EU clinical trial 2024-511474-68-00: A phase II trial of belimumab in combination with rituximab/venetoclax in patients with refractory or relapsed chronic lymphocytic leukemia
Sponsor: Universitaetsklinikum Tuebingen AöR (Hospital/Clinic/Other health care facility). Phase: Therapeutic exploratory (Phase II). Countries: Germany (ended).
Therapeutic area(s): Diseases [C] - Hemic and Lymphatic Diseases [C15]
Gender: Female, Male. Age: 18-64 years, 65+ years. Enrolment: 120.
Status: Ended. Start date (EU): 2022-01-19. End date (EU): 2025-11-12. Decision date: 2024-07-19. Results received: No. Last updated: 2025-11-12.

Condition(s): refractory or relapsed chronic lymphocytic leukemia
Product: BELIMUMAB

Primary endpoint: Negativity rate of minimal residual disease (MRD) in peripheral blood (PB) measured by flow cytometry at EOI
Endpoint(s): Frequency and severity of adverse events (AEs) and serious adverse events (SAEs) through EOT, Frequency and severity of adverse events (AEs) and serious adverse events (SAEs) through EOS, Incidence of suicidal behavior, as determined by Columbia-Suicide Severity Rating Scale (CSSRS), Number and percentage of overall response rate (ORR) according to iwCLL criteria: PR, CR, and CRi at EOT, as assessed by the investigator at EOI and EOT, DOR status as time from best ORR of CR, CRi, or PR until progression, Negativity rate of MRD in PB and BM measured by flow cytometry at EOI, every 3 months during maintenance therapy and at EOS, TTNT as time from d1 to next other CLL treatment, Overall and progression free survival, Overall and progression free survival of patients with 17p deletion, Absolute changes in number and percentage of subjects in lymphocyte subset counts (B, T, NK cells) on day28, d1 of each cycle, EOI and thereafter every 4 weeks until EOT from baseline., Pharmacokinetics of belimumab as assessed as follows: o Observed belimumab concentration at c1d1, EOI and EOT, Overall quality of life scores (EORTC QLQ C-30) until EOS

Source: https://euclinicaltrials.eu/ctis-public/view/2024-511474-68-00